EU clinical trial 2025-521276-59-00: STOP-PKD: SGLT2-inhibition to improve Prognosis in Polycystic Kidney Disease
Protocol code: Uni-Koeln-5522
Sponsor: University Of Cologne (Educational Institution). Phase: Therapeutic confirmatory (Phase III). Countries: Netherlands (ongoing, recruiting), Austria (authorised, recruitment pending), Spain (authorised, recruitment pending), Germany (ongoing, recruiting).
Therapeutic area(s): Diseases [C] - Congenital, Hereditary, and Neonatal Diseases and Abnormalities [C16]
Gender: Female, Male. Age: 18-64 years. Enrolment: 420.
Start date (EU): 2025-12-16. Decision date: 2025-11-06. Results received: No. Last updated: 2026-06-26.
Decision dates by country: ES: 2025-11-07, NL: 2025-11-06, DE: 2025-11-07, AT: 2025-11-10

Condition(s): Autosomal dominant polycystic kidney disease (ADPKD)
Product: Matching Placebo for "Dapagliflozin Ascend 10 mg Filmtabletten", Dapagliflozin Ascend 10 mg Filmtabletten

Primary endpoint: Annual slope of eGFR decline (in mL/min/1,73m2 per year, chronic slope), as calculated with linear mixed models, using all available creatinine values from week 6 until end of treatment (week 156)
Endpoint(s): Off-treatment values: eGFR change from before to after treatment (using the mean of two creatine measurements for each timepoint; week -4 and 0 for before treatment; week 162 and 168 for follow-up), Composite outcome: Sustained 40 % decrease in eGFR from randomization (confirmed by second measurement in next scheduled visit or measured at the last study follow-up visit / the last scheduled visit before death) • OR ESKD: start of dialysis or kidney transplantation or sustained eGFR <15 mL/min/1.73m2 • OR Renal death, Collection of SAEs and AEs of special interest, Change in total kidney volume after 1 year (first 150 patients; baseline – 48 weeks)

Source: https://euclinicaltrials.eu/ctis-public/view/2025-521276-59-00